EU clinical trial 2023-509146-35-00: A Phase 4, multicenter, prospective, open-label study describing the efficacy and safety of belimumab administered subcutaneously in adult participants with early systemic lupus erythematosus
Protocol code: 219240
Sponsor: Glaxosmithkline Research & Development Limited (Pharmaceutical company). Phase: Therapeutic use (Phase IV). Countries: Portugal (ongoing, recruitment ended), France (ongoing, recruitment ended), Greece (ongoing, recruitment ended), Spain (ongoing, recruitment ended), Italy (ongoing, recruitment ended), Germany (ongoing, recruitment ended).
Therapeutic area(s): Diseases [C] - Immune System Diseases [C20]
Gender: Female, Male. Age: 18-64 years, 65+ years. Enrolment: 76.
Status: Ongoing, recruitment ended. Start date (EU): 2025-01-30. Decision date: 2024-10-08. Results received: No. Last updated: 2026-08-07.
Decision dates by country: GR: 2024-10-11, IT: 2024-10-09, FR: 2024-10-10, ES: 2024-11-22, DE: 2024-12-20, PT: 2024-10-08

Condition(s): Systemic Lupus Erythematosus
Product: Benlysta 200 mg solution for injection in pre-filled pen.

Primary endpoint: Achieving LLDAS at Week 52.
Endpoint(s): Achieving SRI4 at Week 52., Achieving LLDAS for ≥25% of time from Day 1 to Week 52., Achieving average oral prednisone equivalent dose ≤5 mg/day at Week 52., Incidence of severe flare (modified SFI) as assessed at Week 52., Part B: Achieving DORIS remission at Week 104., Part B: Maintaining an SDI of 0 at Week 156., Part B: Incidence of AEs, SAEs and AESI up to Week 104 and up to Week 156.

Source: https://euclinicaltrials.eu/ctis-public/view/2023-509146-35-00